EU clinical trial 2024-516168-27-00: RITUX-PLUS 2 : A phase 3 randomized and double-blind controlled trial comparing the efficacy and safety of rituximab combined with subcutaneous belimumab versus rituximab + placebo in adult patients with persistent or chronic immune thrombocytopenia (ITP)
Protocol code: APHP201098
Sponsor: Assistance Publique Hopitaux De Paris (Hospital/Clinic/Other health care facility). Phase: Therapeutic confirmatory (Phase III). Countries: France (ongoing, recruitment ended).
Therapeutic area(s): Diseases [C] - Immune System Diseases [C20]
Gender: Female, Male. Age: 18-64 years, 65+ years. Enrolment: 132.
Status: Ongoing, recruitment ended. Start date (EU): 2022-11-10. Decision date: 2024-11-29. Results received: No. Last updated: 2026-03-05.

Condition(s): Adult patients with persistent or chronic immune thrombocytopenia
Product: PLACEBO OF BELIMUMAB, Benlysta 200 mg solution for injection in pre-filled pen.

Primary endpoint: The overall response rate (CR + R) in both arms at W52
Endpoint(s): Total number of responders (responders + complete responses) at W6, W12, W 24, W36, W52, W78, W104., Duration of severe hypogammaglobulinemia in patients with such complication, Number of patients developing a severe hypogammaglobulinemia (gammaglobulin level < 4 g/dl) in both arms at W12, W24, W36, W52, W78, W104, Variation in gammaglobulin classes and subclass levels throughout the study (W0, W12, W24, W36, W52, W78, W104), Number of severe infections requiring hospitalization during the study, Number of haemorrhagic events evaluated by the Khellaf Score at W6, W12, W24, W36, W52, W78, W104., Platelet levels at W6, W12, W 24, W36, W52, W78, W104, Use of the SF-36 health questionnaire and FACIT-Fatigue scale (Functional assessment of chronic illness therapy) to assess patient’s quality of life at inclusion, W12, W24 and W52, Percentage of each B-cell subpopulation, T Follicular helper population and levels of cytokines (including BAFF) and anti-platelet antibodies at W12, W24, W36, W52, W78, W104.

Source: https://euclinicaltrials.eu/ctis-public/view/2024-516168-27-00